EU clinical trial 2024-518360-13-00: A First-in-Human phase 1, open-label, two-stage, randomized trial to assess the safety, tolerability, and biodistribution of [177Lu]Lu-ABY-271 in tumors and critical organs in subjects with HER2-positive metastatic breast cancer
Protocol code: ABY-271-101
Sponsor: Affibody AB (Pharmaceutical company). Phase: Human Pharmacology (Phase I)- First administration to humans. Countries: Sweden (ongoing, recruiting), Germany (authorised, recruitment pending), Norway (authorised, recruitment pending).
Therapeutic area(s): Diseases [C] - Neoplasms [C04]
Gender: Female. Age: 18-64 years, 65+ years. Enrolment: 24.
Start date (EU): 2025-06-18. Decision date: 2025-04-23. Results received: No. Last updated: 2026-08-05.
Decision dates by country: SE: 2025-04-23, DE: 2025-04-24, NO: 2026-08-05

Condition(s): HER2-positive metastatic breast cancer

Primary endpoint: Part A and Part B: Treatment emergent adverse events (TEAEs), serious adverse events (SAEs), dose limiting toxicities (DLTs), Part A and Part B: Changes in safety laboratory parameters, vital signs, ECHO, and 12-lead ECG
Endpoint(s): Part A and Part B: Absorbed dose in gray (Gy) per organ and selected tumors, Part A and Part B: Absorbed dose coefficient (Gy/GBq) per organ and selected tumors, Part A and Part B: Normalized whole-body effective dose (millisieverts [mSv]/MBq), Part A and Part B: Time Activity Curves (%ID) for organs and selected tumors, Part A and Part B: Plasma concentration of ABY-271 protein after [177Lu]Lu-ABY-271 IV infusion, Part A and Part B: Radioactivity concentration in blood of [177Lu]Lu-ABY-271 (kBq/mL), Part A and Part B: Blood PK parameters including tmax, Cmax, Cl, AUC, Vd, MRT, t1/2, λ, Part A and Part B: Occurrence of ADAs and change in ADA titers compared to baseline, Part A only: Tumor to background absorbed dose ratio for selected organs (e.g., kidney, liver, red marrow), Part A: Tumor to background ratio of activity uptake for selected organs (e.g., kidney, liver, blood), Part B only: Tumor to background absorbed dose ratio for selected organs (e.g., kidney, liver, red marrow), Part B: Tumor to background ratio of activity uptake for selected organs (e.g., kidney, liver, blood), Part B:Objective tumor response as per RECIST v.1.1

Source: https://euclinicaltrials.eu/ctis-public/view/2024-518360-13-00